EU clinical trial 2022-501725-21-00: A phase I safety, dose finding and feasibility trial of GD2IL18CART in patients with relapsed or refractory GD2 positive solid cancers
Protocol code: WWU19_0008
Sponsor: Universitaet Muenster (Educational Institution). Phase: Human Pharmacology (Phase I)- First administration to humans. Countries: Germany (ongoing, recruiting).
Therapeutic area(s): Diseases [C] - Neoplasms [C04]
Gender: Female, Male. Age: 0-17 years, 18-64 years, 65+ years. Enrolment: 48.
Status: Ongoing, recruiting. Start date (EU): 2024-04-12. Decision date: 2024-03-19. Results received: No. Last updated: 2026-06-25.

Condition(s): Ewing sarcoma, Osteosarcoma, Neuroblastoma, Advanced breast cancer
Product: ANAKINRA, PARACETAMOL, DEXAMETHASONE, CLEMASTINE, GD2IL18CART, CYCLOPHOSPHAMIDE, TOCILIZUMAB, LEVETIRACETAM, FLUDARABINE

Primary endpoint: Overall incidence and severity of AEs (CTCAE version 5.0), Dose-finding part: RD of GD2IL18CART based on the maximum tolerated dose (MTD) selected by the Bayesian Optimal Interval (BOIN) Design decision rules (posterior DLT estimate closest to target toxicity, i.e. 20%) until day 28 after GD2IL18CART and on the basis of safety and efficacy., Dose extension part: Overall response rate (ORR) defined as the rate of complete (CR) or partial (PR) remissions at week 12 by imRECIST.
Endpoint(s): In vivo persistence/immune function of GD2IL18CART, Proportion of patients for whom a GD2IL18CART product can be generated, Best response, Duration of response, relapse rate and time to relapse, Disease-free and overall survival at 1 year

Source: https://euclinicaltrials.eu/ctis-public/view/2022-501725-21-00